EU clinical trial 2024-512243-23-00: Three versus five years of adjuvant imatinib as treatment of patients with operable GIST with a high risk for recurrence: A randomised phase III study.
Sponsor: Region Skane (Hospital/Clinic/Other health care facility). Phase: Therapeutic confirmatory (Phase III). Countries: Sweden (ongoing, recruitment ended), Finland (ongoing, recruitment ended), Norway (ongoing, recruitment ended), Germany (ongoing, recruitment ended), Austria (ongoing, recruitment ended), Netherlands (ongoing, recruitment ended), Spain (ongoing, recruitment ended), Denmark (ongoing, recruitment ended).
Therapeutic area(s): Diseases [C] - Neoplasms [C04]
Gender: Female, Male. Age: 18-64 years, 65+ years. Enrolment: 205.
Status: Ongoing, recruitment ended. Start date (EU): 2014-11-07. Decision date: 2024-10-03. Results received: No. Last updated: 2026-02-27.
Decision dates by country: AT: 2024-10-08, DK: 2024-10-08, DE: 2024-10-10, ES: 2024-10-14, NL: 2024-10-10, NO: 2024-10-04, FI: 2024-10-04, SE: 2024-10-03

Condition(s): gastrointestinal stromal tumor
Product: Glivec 100 mg film-coated tablets

Primary endpoint: Recurrence-free survival (RFS). Defined by the time interval between the date of randomisation and the date of first detection of GIST recurrence or death, whichever occurs first. CT/MRI at 6-month intervals during the first 5 years on study in each arm, and then annually.
Endpoint(s): Overall survival., GIST-specific survival. The time period between the date of randomisation and the date of death considered to be caused by GIST; patients who die from other causes are censored on the date of death., Safety., Quality of Life

Source: https://euclinicaltrials.eu/ctis-public/view/2024-512243-23-00